EU clinical trial 2024-520125-36-00: A Phase 1b Study of the Safety and Pharmacokinetics of Pivekimab Sunirine in Pediatric Subjects with Relapsed or Refractory Acute Myeloid Leukemia (AML).
Protocol code: M25-692
Sponsor: AbbVie Deutschland GmbH & Co. KG (Pharmaceutical company). Phase: Human Pharmacology (Phase I)- Other. Countries: Spain (authorised, recruitment pending), Hungary (authorised, recruitment pending), Czechia (authorised, recruitment pending), France (authorised, recruiting), Italy (authorised, recruiting), Belgium (authorised, recruitment pending).
Therapeutic area(s): Diseases [C] - Neoplasms [C04]
Gender: Female, Male. Age: 0-17 years. Enrolment: 18.
Start date (EU): 2026-07-08. Decision date: 2026-04-20. Results received: No. Last updated: 2026-07-22.
Decision dates by country: HU: 2026-04-24, BE: 2026-04-20, FR: 2026-04-22, IT: 2026-04-24, ES: 2026-04-22, CZ: 2026-04-22

Condition(s): Relapsed or Refractory Acute Myeloid Leukemia; Acute Myeloid Leukemia, Acute Myeloid Leukemia
Product: PIVEKIMAB SUNIRINE

Primary endpoint: Treatment-emergent adverse events (TEAEs) leading to treatment discontinuation, PK parameters for intact ADC and payload (FGN849), including Cmax, AUC, and Tmax
Endpoint(s): Complete Remission (CR), Composite Complete Remission (CR + CRi), Composite Complete Remission (CR + CRh), Duration of Complete Remission (DOCR), Duration of Composite Complete Remission (CR + CRi), Duration of Composite Complete Remission (CR + CRh)

Source: https://euclinicaltrials.eu/ctis-public/view/2024-520125-36-00